EU clinical trial 2024-518689-29-00: A multicenter, open-label, prospective study to assess the concentration of bimekizumab in mature breast milk from mothers receiving treatment with Bimzelx® (bimekizumab)
Protocol code: UP0122
Sponsor: UCB Biopharma (Pharmaceutical company). Phase: Human Pharmacology (Phase I)- Other. Countries: Spain (authorised, recruitment pending), Germany (authorised, recruitment pending).
Therapeutic area(s): Diseases [C] - Immune System Diseases [C20]
Gender: Female. Age: 18-64 years, 65+ years. Enrolment: 8.
Status: Authorised, recruitment pending. Decision date: 2025-07-03. Results received: No. Last updated: 2026-07-29.
Decision dates by country: DE: 2025-07-03, ES: 2025-07-07

Condition(s): Hidradenitis suppurativa, Psoriatic arthritis, Axial spondyloarthritis, Moderate to Severe Plaque Psoriasis
Product: Bimzelx 160 mg solution for injection in pre-filled pen, Bimzelx 160 mg solution for injection in pre-filled syringe, Bimzelx 160 mg solution for injection in pre-filled syringe, Bimzelx 320 mg solution for injection in pre-filled pen, Bimzelx 160 mg solution for injection in pre-filled pen, Bimzelx 160 mg solution for injection in pre-filled pen, Bimzelx 160 mg solution for injection in pre-filled syringe, Bimzelx 320 mg solution for injection in pre-filled syringe, Bimzelx 320 mg solution for injection in pre-filled syringe, Bimzelx 160 mg solution for injection in pre-filled pen, Bimzelx 160 mg solution for injection in pre-filled syringe, Bimzelx 320 mg solution for injection in pre-filled pen

Primary endpoint: Concentration of bimekizumab in the breast milk predose on Day 1 and on Days 2, 3, 5, 7, 9, 11, 13, and 15 (predose for mothers on Q2W dosing regimen), and in addition, predose on Day 29 or Day 57 for mothers on Q4W or Q8W dosing regimen, respectively
Endpoint(s): Estimated Infant Dosage of bimekizumab from breast milk, Relative Infant Dose of bimekizumab from breast milk, Treatment-emergent adverse events (TEAEs) of the mother from time of informed consent through Safety Follow-Up (SFU) contact

Source: https://euclinicaltrials.eu/ctis-public/view/2024-518689-29-00